EU clinical trial 2024-513658-31-00: Phase II, Multi-Center, Randomized, Blinded Study Evaluating the Efficacy, Safety and Tolerability of a Single Intratympanic Dose of AC102 Compared to Oral Steroids for the Treatment of Idiopathic Sudden Sensorineural Hearing Loss
Protocol code: AC102-201
Sponsor: AudioCure Pharma GmbH (Pharmaceutical company). Phase: Therapeutic exploratory (Phase II). Countries: Poland (ended), Czechia (ended), Germany (ended), Austria (ended), Netherlands (ended).
Therapeutic area(s): Diseases [C] - Otorhinolaryngologic Diseases [C09]
Gender: Female, Male. Age: 18-64 years, 65+ years. Enrolment: 182.
Status: Ended. Start date (EU): 2022-08-08. End date (EU): 2026-01-15. End date: 2026-01-16. Decision date: 2024-07-10. Results received: No. Last updated: 2025-10-28.
Decision dates by country: PL: 2024-08-06, NL: 2024-07-12, CZ: 2024-07-10, AT: 2024-07-15, DE: 2024-07-10

Condition(s): Idiopathic Sudden Sensorineural Hearing Loss
Product: AC102-Suspension 12 mg/ml, placebo gel, Placebo matching Prednisolone, Prednisolon 10 mg GALEN®

Primary endpoint: Mean change in absolute hearing thresholds (average of the three most affected consecutive frequencies from 0.25 to 8 kHz) measured by PTA from baseline to Day 28
Endpoint(s): Absolute improvement of speech recognition from baseline to Day 84, Mean change in absolute hearing thresholds of PTA from baseline to Day 14, 56 and 84 at the three mostly affected consecutive frequencies and mean change of 4PTA (PTA at the frequencies 0.5, 1, 2, and 4 kHz), Percentage of patients with complete, partial or no remission on Day 28, 56 and 84 (no recovery: ≤ 10 dB, complete: within 10 dB to the contralateral ear), Percentage of patients qualifying for a hearing aid or a cochlear implant at Day 84, Absolute improvement of speech recognition in quiet from baseline to Day 14, 28 and 56, Percentage of patients eligible for salvage therapy, Improvement of scoring in HHIA from baseline to Day 28 and 84, Mean change in absolute hearing thresholds of PTA from baseline to Day 14, 28, 56 and 84 at the three mostly affected consecutive frequencies and mean change of 4PTA (PTA at the frequencies 0.5, 1, 2, and 4 kHz) in patients with a baseline hearing threshold of ≥80 dB

Source: https://euclinicaltrials.eu/ctis-public/view/2024-513658-31-00